EU clinical trial 2023-507847-13-00: A randomized intrapatient cross-over study to assess the efficacy of oxybutynin versus venlafaxine in REDucing hot FLASHes in women using endocrine therapy after breast cancer: the RED FLASH study.
Sponsor: Reinier de Graaf Groep (Hospital/Clinic/Other health care facility). Phase: Therapeutic confirmatory (Phase III). Countries: Netherlands (ongoing, recruiting).
Therapeutic area(s): Diseases [C] - Neoplasms [C04]; Not possible to specify
Gender: Female. Age: 18-64 years, 65+ years. Enrolment: 67.
Status: Ongoing, recruiting. Start date (EU): 2024-08-09. Decision date: 2024-04-09. Results received: No. Last updated: 2026-02-16.

Condition(s): Breast cancer
Product: TAMOXIFEN, LETROZOLE, ANASTROZOLE, FULVESTRANT, LEUPRORELIN, OXYBUTYNIN, GOSERELIN, VENLAFAXINE, LEUPRORELIN, GOSERELIN, EXEMESTANE, VENLAFAXINE

Primary endpoint: Number and severity of hot flashes during 6-week therapy measured by the Hot Flash Diary on a daily basis.
Endpoint(s): Adverse events, sleep quality, quality of life, health status, anxiety and depression, cognitive function, sexual function, personal preference, adherence

Source: https://euclinicaltrials.eu/ctis-public/view/2023-507847-13-00